EU clinical trial 2024-517983-47-00: An Open-label Extension Study Evaluating the Long-term Safety, Tolerability, Efficacy, Pharmacokinetics, and Pharmacodynamics of VX-670 in Adult Subjects with Myotonic Dystrophy Type I
Protocol code: VX-24-670-101
Sponsor: Vertex Pharmaceuticals Inc. (Pharmaceutical company). Phase: Phase I and Phase II (Integrated)- Other. Countries: Netherlands (ongoing, recruiting), France (authorised, recruitment pending), Italy (authorised, recruitment pending), Spain (ongoing, recruiting), Germany (ongoing, recruiting), Belgium (ongoing, recruiting).
Therapeutic area(s): Diseases [C] - Musculoskeletal Diseases [C05]
Gender: Female, Male. Age: 18-64 years. Enrolment: 20.
Start date (EU): 2025-11-25. Decision date: 2025-06-03. Results received: No. Last updated: 2026-04-09.
Decision dates by country: BE: 2025-07-01, NL: 2025-06-03, ES: 2025-07-01, IT: 2025-06-04, FR: 2025-06-04, DE: 2025-07-01

Condition(s): Myotonic Dystrophy
Product: VX-670 Solution for Injection/Infusion

Primary endpoint: Safety and tolerability of VX-670 based on the assessment of adverse events (AEs), vital signs, electrocardiograms (ECGs), and clinical laboratory values
Endpoint(s): VX-670 and PMO-0221a concentrations in plasma

Source: https://euclinicaltrials.eu/ctis-public/view/2024-517983-47-00